EU clinical trial 2024-515204-39-00: A phase II, single arm study investigating neoadjuvant plus adjuvant treatment with Cemiplimab in surgically resectable, high risk stage III/IV (M0) Cutaneaous Squamous Cell Carcinoma
Protocol code: NEO-CESQ
Sponsor: Fondazione Melanoma Onlus (Laboratory/Research/Testing facility). Phase: Therapeutic exploratory (Phase II). Countries: Italy (ongoing, recruiting).
Therapeutic area(s): Diseases [C] - Skin and Connective Tissue Diseases [C17]
Gender: Female, Male. Age: 18-64 years, 65+ years. Enrolment: 25.
Status: Ongoing, recruiting. Start date (EU): 2021-02-10. Decision date: 2024-11-25. Results received: No. Last updated: 2026-05-26.

Condition(s): surgically resectable, high risk stage III/IV (M0) Cutaneaous Squamous Cell Carcinoma, Cutaneaous Squamous Cell Carcinoma
Product: CEMIPLIMAB

Primary endpoint: major pathological response rate (<10% remaining viable tumour cells in resected primary tumor)., Recurrence-free survival (RFS - the time from start of treatment until disease recurrence (local, regional or distant) or death from any cause), Overall Survival (OS - the length of time from either the date of diagnosis or the start of treatment for a disease, such as cancer, that patients diagnosed with the disease are still alive), Safety, To determine molecular and immunophenotypic changes in tumor and peripheral blood evaluating several biomarkers. Since the identification of new markers for immunotherapy is rapidly evolving, the definitive list of analyses remains to be determined

Source: https://euclinicaltrials.eu/ctis-public/view/2024-515204-39-00